EU clinical trial 2023-509853-29-00: A randomized, phase II/III trial on the biological and clinical effects of acetyl-L-carnitine in ALS
Sponsor: Istituto Di Ricerche Farmacologiche Mario Negri (Laboratory/Research/Testing facility). Phase: Phase II and Phase III (Integrated). Countries: Italy (ongoing, recruiting).
Therapeutic area(s): Diseases [C] - Musculoskeletal Diseases [C05]
Gender: Female, Male. Age: 18-64 years, 65+ years. Enrolment: 236.
Status: Ongoing, recruiting. Start date (EU): 2025-02-24. Decision date: 2025-02-07. Results received: No. Last updated: 2026-05-29.
Decision dates by country: IT: 2025-04-22

Condition(s): amyotrophic lateral sclerosis
Product: Nicetile 500 mg polvere per soluzione orale, PLACEBO

Primary endpoint: The proportion of participants remaining self-sufficient after 48 weeks in each treatment arm (those scoring three or higher in all the three ALSFRS-R items for swallowing, cutting food, handling utensils, and walking).
Endpoint(s): Mean change of ALSFRS-R total score in each treatment arm from baseline to week 48., Mean change of FVC% in each treatment arm from baseline to week 48., Mean change in the five domains of ALSAQ-40 measuring different aspects of quality of life (physical mobility, ADL/independence, eating and drinking, emotional reactions, communication) in each treatment arm from baseline to week 48., Mean change in ECAS total score in each treatment arm from baseline to week 48., Cumulative probability of remaining self-sufficient in each treatment arm during 48 weeks., Cumulative probability of remaining free from a 6-point or greater decline in ALSFRS-R total score in each treatment arm during 48 weeks., Cumulative probability of remaining without gastrostomy in each treatment arm during 48 weeks., Cumulative probability of remaining without non-invasive ventilation (NIV) support (≥12 hours a day in a 24-hour period) in each treatment arm during 48 weeks., Cumulative survival probability (of being alive and without tracheostomy) in each treatment arm during 48 weeks, The mean change in the levels of PGC-1 alpha, 3-NT, acetyl-PPIA in the peripheral blood mononuclear cells (PBMCs) and of NFL, MMP-9, MCP-1, CK, MiR-206, Musclin/osteocrin, Uric acid, HNE in plasma in each treatment arm, during the entire treatment period (from baseline to 48 weeks)., Number of adverse events and serious adverse events in each treatment arm during 48 weeks of treatment.

Source: https://euclinicaltrials.eu/ctis-public/view/2023-509853-29-00